EU clinical trial 2022-500814-24-00: An Investigator-Initiated Prospective Randomized Open-Label Blinded-Endpoint Crossover Trial Comparing the Effect and Safety of Flecainide and Metoprolol versus Metoprolol Alone to Suppress Ventricular Arrhythmias in Arrhythmic Mitral Valve Prolapse (FLECAPRO).
Sponsor: Oslo University Hospital Hf (Hospital/Clinic/Other health care facility). Phase: Therapeutic confirmatory (Phase III). Countries: Norway (ongoing, recruiting).
Therapeutic area(s): Diseases [C] - Cardiovascular Diseases [C14]
Gender: Female, Male. Age: 18-64 years, 65+ years. Enrolment: 50.
Status: Ongoing, recruiting. Start date (EU): 2023-01-04. Decision date: 2022-09-27. Results received: No. Last updated: 2025-02-19.

Condition(s): Arrhythmic mitral valve prolapse
Product: METOPROLOL, METOPROLOL, FLECAINIDE

Primary endpoint: Number of ventricular tachyarrhythmias, composite of: a) Ventricular tachycardia b) Ventricular fibrillation.
Endpoint(s): Burden of premature ventricular complexes (by 24-hour Holter monitoring), Health-related quality of life (number of patients with ≥5 points increase in SF-36 overall summary score), Number of severe ventricular tachycardias, composite of: a) Non-sustained ventricular tachycardia with syncope b) Sustained ventricular tachycardia c) Ventricular fibrillation

Source: https://euclinicaltrials.eu/ctis-public/view/2022-500814-24-00